EU clinical trial 2023-508137-14-00: A Phase 2, Single-Arm, Open-Label Extension Study, Evaluating the Long-Term Safety and Clinical Efficacy of SAR447537 (INBRX-101) in Adults with Alpha-1 Antitrypsin Deficiency (AATD) Emphysema
Protocol code: INBRX101-01-202
Sponsor: Sanofi AATD Inc. (Pharmaceutical company). Phase: Therapeutic exploratory (Phase II). Countries: Spain (ongoing, recruitment ended), Sweden (ongoing, recruitment ended), Denmark (ongoing, recruitment ended), Poland (ongoing, recruitment ended), Ireland (ongoing, recruitment ended).
Therapeutic area(s): Diseases [C] - Respiratory Tract Diseases [C08]; Diseases [C] - Congenital, Hereditary, and Neonatal Diseases and Abnormalities [C16]
Gender: Female, Male. Age: 18-64 years, 65+ years. Enrolment: 48.
Status: Ongoing, recruitment ended. Start date (EU): 2025-03-11. Decision date: 2024-09-17. Results received: No. Last updated: 2026-06-10.
Decision dates by country: PL: 2024-09-22, ES: 2024-09-17, IE: 2024-09-20, SE: 2024-09-19, DK: 2024-09-19

Condition(s): Alpha-1 Antitrypsin Deficiency (AATD) Emphysema
Product: INBRX-101 Concentrate for Solution for Infusion 50mg/ml

Primary endpoint: Incidences of all treatment-emergent adverse events (TEAEs), TEAEs ≥Grade 3, serious adverse events (SAEs), TEAEs requiring withdrawal from investigational product (IP) treatment leading to discontinuation from SAR447537, and adverse events of special interest (AESIs) (including infusion-related reactions) leading to discontinuation from and adverse events of special interest (AESIs) (including infusion-related reactions).
Endpoint(s): Annual rate of change in lung density assessed by serial quantitative CT (15th percentile point [PD15]) at total lung capacity (TLC), centrally read, from Baseline to End of Treatment (EoT)., Serum PK profile of SAR447537 and fAAT., Population PK modeling to assess impact of physiologically relevant participant characteristics (eg, covariates including, but not limited to, age, sex, body size, ethnicity) and disease on PK of SAR447537 through Population PK modeling., Incidence of anti-drug antibodies (ADAs) against SAR447537 as well as neutralizing anti-drug antibodies (NAbs) against SAR447537.

Source: https://euclinicaltrials.eu/ctis-public/view/2023-508137-14-00